EU clinical trial 2024-512728-12-00: A randomized clinical trial to compare topical lidocaine-prilocaine cream (Emla) versus 2% lidocaine infiltration to first-degree perineal tears repair
Protocol code: DES-26-E(C)A
Sponsor: Fundacion Para El Fomento De La Investigacion Sanitaria Y Biomedica De La Comunitat Valenciana (Patient organisation/association). Phase: Therapeutic use (Phase IV). Countries: Spain (ongoing, recruiting).
Therapeutic area(s): Diseases [C] - Female Urogenital Diseases and Pregnancy Complications [C13]
Gender: Female. Age: 18-64 years. Enrolment: 84.
Status: Ongoing, recruiting. Start date (EU): 2024-08-12. Decision date: 2024-07-23. Results received: No. Last updated: 2026-03-31.

Condition(s): First-dregree perineal laceration
Product: Lidocaína B. Braun 20 mg/ml solución inyectable, EMLA 25 mg/g + 25 mg/g crema

Primary endpoint: The values of the Visual Analogue Scale (VAS) of pain modified according to how they express women.
Endpoint(s): Characteristics of the tear: location., Characteristics of childbirth and postpartum: onset of labor, use of alternative therapies to pain management and performing uninterrupted skin-to-skin for the two hours postpartum (except when the newborn is weighed)., Characteristics of the newborn: weight and sex., Characteristics of women: parity and age.

Source: https://euclinicaltrials.eu/ctis-public/view/2024-512728-12-00